EU clinical trial 2025-522723-98-00: A Phase 1/2 Study of Inhaled KB707 in Patients with Advanced Solid Tumor Malignancies Affecting the Lungs
Protocol code: KB707-02
Sponsor: Krystal Biotech Inc. (Pharmaceutical company). Phase: Phase I and Phase II (Integrated)- Other. Countries: France (authorised, recruitment pending), Spain (authorised, recruitment pending).
Therapeutic area(s): Diseases [C] - Neoplasms [C04]
Gender: Female, Male. Age: 18-64 years, 65+ years. Enrolment: 40.
Status: Authorised, recruitment pending. Decision date: 2026-06-30. Results received: No. Last updated: 2026-07-02.
Decision dates by country: FR: 2026-07-02, ES: 2026-06-30

Condition(s): solid tumor
Product: DOCETAXEL, KB707

Primary endpoint: Frequency, severity, and relatedness of Adverse Events (AEs) and Serious Adverse Events (SAEs)
Endpoint(s): Incidence of Dose-Limiting Toxicity (DLT) by dose cohorts, Assessment of the objective response rate (ORR), complete response (CR), clinical benefit rate (CBR), duration of response (DOR), time to response (TTR), progression free survival (PFS), and overall survival (OS)

Source: https://euclinicaltrials.eu/ctis-public/view/2025-522723-98-00